EU clinical trial 2025-523339-20-00: A dose-ranging randomized, open-label study evaluating the effect of bilateral intravitreal injection of GS010 at two dose levels on visual acuity and retinal mitochondrial activity in patients affected with ND4 Leber Hereditary Optic Neuropathy – The REVISE Study
Protocol code: GS-LHON-CLIN-08
Sponsor: Gensight Biologics (Pharmaceutical company). Phase: Therapeutic exploratory (Phase II). Countries: France (ongoing, recruiting).
Therapeutic area(s): Diseases [C] - Eye Diseases [C11]
Gender: Female, Male. Age: 0-17 years, 18-64 years, 65+ years. Enrolment: 14.
Status: Ongoing, recruiting. Start date (EU): 2026-01-20. Decision date: 2025-12-02. Results received: No. Last updated: 2026-07-08.
Decision dates by country: FR: 2026-01-06

Condition(s): Leber Hereditary Optic Neuropathy due to mutations in the mitochondrial NADH Dehydrogenase 4 gene
Product: Lumevoq

Primary endpoint: BCVA change from baseline to 1.5 years post-treatment in the study eyes.
Endpoint(s): BCVA responder rates from baseline to 1.5 years post-treatment in the study eyes, defined as an improvement of at least -0.2 LogMAR., BCVA change from baseline to 1.5 years post-treatment in both eyes., Difference between ARM H and ARM L in BCVA change from baseline to 1.5 years post-treatment in the study eyes., Frequency and severity of ocular adverse events (AEs)., Frequency and severity of ocular AEs of special interest (AESIs) post-GS010 administration: o Intraocular inflammation; evolution with time and response to corticosteroid. o Increase in intraocular pressure (IOP); evolution with time and response to IOP lowering treatment., Frequency and severity of non-ocular AEs.

Source: https://euclinicaltrials.eu/ctis-public/view/2025-523339-20-00